EU clinical trial 2024-515752-21-00: First-in-Human, Open-Label, Dose Escalation Trial With Expansion Cohorts to Evaluate Safety and Preliminary Efficacy of GEN1078 in Subjects With Malignant Solid Tumors
Protocol code: GCT1078-01
Sponsor: Genmab A/S (Pharmaceutical company). Phase: Phase I and Phase II (Integrated)- First administration to humans. Countries: Denmark (ended), Spain (ended).
Therapeutic area(s): Diseases [C] - Neoplasms [C04]
Gender: Female, Male. Age: 18-64 years, 65+ years. Enrolment: 41.
Status: Ended. Start date (EU): 2025-01-29. End date (EU): 2025-06-11. Decision date: 2024-12-20. Results received: Yes. Last updated: 2025-05-20.
Decision dates by country: ES: 2025-01-15, DK: 2024-12-20

Condition(s): Malignant solid tumors
Product: GEN1078 DP

Primary endpoint: Dose Escalation: Number of Participants with Dose-limiting Toxicities (DLTs), Dose Escalation: Number of Participants with Adverse Events (AEs), Dose Expansion: Confirmed Objective Response Rate (ORR).
Endpoint(s): Dose-Escalation and Expansion: Clearance (CL) of GEN1078, Dose-Escalation and Expansion: Volume of Distribution (Vd) of GEN1078, Dose-Escalation and Expansion: Area Under the Concentration-Time Curve from Time Zero to Last Quantifiable Concentration (AUC0-last) of GEN1078, Dose-Escalation and Expansion: Area Under the Concentration-Time Curve from Time Zero to Infinity (AUC0-∞) of GEN1078, Dose-Escalation and Expansion: Maximum Observed Plasma Concentration (Cmax) of GEN1078, Dose-Escalation and Expansion: Time to Reach Cmax (Tmax) for GEN1078, Dose-Escalation and Expansion: Predose Concentration for GEN1078, Dose-Escalation and Expansion: Terminal Half-life (t½) of GEN1078, Dose-Escalation and Expansion: Number of Participants with Anti-drug Antibodies (ADAs), Dose Escalation: Confirmed ORR., Dose-Escalation and Expansion: Duration of Response (DOR)., Dose-Escalation and Expansion: Disease Control Rate (DCR)., Dose-Escalation and Expansion: Time to Response (TTR)., Dose Expansion: Number of Participants with AEs

Source: https://euclinicaltrials.eu/ctis-public/view/2024-515752-21-00